EU clinical trial 2025-522267-15-00: A Phase 2/3, Randomized, Open-Label, Comparison Study of MK-1045 Versus Blinatumomab in Participants With Relapsed or Refractory CD19+ B-Cell Acute Lymphoblastic Leukemia (B-ALL)
Protocol code: MK-1045-005
Sponsor: Merck Sharp & Dohme LLC (Pharmaceutical company). Phase: Phase II and Phase III (Integrated). Countries: Greece (authorised, recruiting), Netherlands (authorised, recruiting), Sweden (authorised, recruitment pending), France (authorised, recruitment pending), Italy (ongoing, recruiting), Spain (authorised, recruiting), Denmark (authorised, recruiting).
Therapeutic area(s): Diseases [C] - Neoplasms [C04]
Gender: Female, Male. Age: 0-17 years, 18-64 years, 65+ years. Enrolment: 109.
Start date (EU): 2026-06-24. Decision date: 2026-06-12. Results received: No. Last updated: 2026-07-30.
Decision dates by country: DK: 2026-06-15, FR: 2026-06-16, ES: 2026-06-15, SE: 2026-06-15, IT: 2026-06-15, GR: 2026-06-12, NL: 2026-06-12

Condition(s): Relapsed/refractory B-cell Acute Lymphoblastic Leukemia
Product: BLINATUMOMAB, MK-1045, TOCILIZUMAB

Primary endpoint: Part 1: Complete remission (CR) within the first 3 treatment cycles, Part 1: Number of participants with an adverse event (AE), Part 1: Number of participants discontinuing from study therapy due to AE, Part 2: Percentage of participants with CR within the first 3 treatment cycles, Part 2: Overall survival (OS)
Endpoint(s): Part 1: OS, Part 1: Percentage of participants with minimal residual disease (MRD) negativity within the first 3 treatment cycles, Part 1: Percentage of participants with CR, complete remission with partial hematologic recovery (CRh), or complete remission with incomplete count recovery (CRi) within the first 3 treatment cycles, Part 2: Percentage of participants with MRD negativity within the first 3 treatment cycles, Part 2: Percentage of participants with CR or CRh within the first 3 treatment cycles, Part 2: Percentage of participants with CR, CRh, or CRi within the first 3 treatment cycles, Part 2: Duration of CR, Part 2: Duration of CR/CRh, Part 2: Duration of CR, CRh, or CRi, Part 2: Event free survival (EFS), Part 2: Percentage of participants who undergo allogeneic hematopoietic stem cell transplantation (allo-HSCT), Part 2: Percentage of participants who experienced an adverse event (AE), Part 2: Percentage of participants who discontinued study intervention due to an AE

Source: https://euclinicaltrials.eu/ctis-public/view/2025-522267-15-00